EU clinical trial 2024-516356-18-00: A randomized, double-blind, placebo-controlled, multicenter study to evaluate the efficacy, safety, and tolerability of pelacarsen (TQJ230) with background inclisiran in participants with atherosclerotic cardiovascular disease, and elevated LDL-C and Lp(a)
Protocol code: CTQJ230A12304
Sponsor: Novartis Pharma AG (Pharmaceutical company). Phase: Therapeutic confirmatory (Phase III). Countries: Germany (ongoing, recruiting), Netherlands (ongoing, recruiting), Spain (ongoing, recruiting), Italy (ongoing, recruiting), France (ongoing, recruiting).
Therapeutic area(s): Diseases [C] - Cardiovascular Diseases [C14]
Gender: Female, Male. Age: 18-64 years, 65+ years. Enrolment: 166.
Status: Ongoing, recruiting. Start date (EU): 2026-02-17. Decision date: 2025-08-05. Results received: No. Last updated: 2026-07-31.
Decision dates by country: FR: 2025-08-06, ES: 2025-08-06, IT: 2025-08-06, NL: 2025-08-11, DE: 2025-08-05

Condition(s): Atherosclerotic cardiovascular disease (ASCVD)
Product: Placebo to TQJ230 80 mg/0.8 mL Solution for injection in pre-filled syringe with needle safety device, INCLISIRAN, TQJ230

Primary endpoint: Change in log-transformed Lp(a) concentration from baseline at Month 6
Endpoint(s): Proportion of participants achieving Lp(a) levels <125 nmol/L at Month 6, Incidence of treatment emergent adverse events (TEAEs):, Incidence of treatment emergent serious adverse events (TESAEs), Incidence of treatment emergent adverse events of special interest (AESI), Incidence of study and treatment discontinuations due to TEAEs;, Observed value and change/shift from baseline in safety laboratory measures; • ECGs • Vital signs • Laboratory values (e.g. CBC, CMP, Liver Function Tests)

Source: https://euclinicaltrials.eu/ctis-public/view/2024-516356-18-00